EU clinical trial 2023-505128-76-00: A Phase 1/2 Trial of AAVAnc80-hOTOF Gene Therapy in Individuals with Sensorineural Hearing Loss due to Biallelic Otoferlin Gene (OTOF) Mutations
Protocol code: AK-OTOF-101
Sponsor: Akouos Inc. (Pharmaceutical company). Phase: Phase I and Phase II (Integrated)- First administration to humans. Countries: Spain (authorised, recruitment pending).
Therapeutic area(s): Diseases [C] - Congenital, Hereditary, and Neonatal Diseases and Abnormalities [C16]; Diseases [C] - Otorhinolaryngologic Diseases [C09]
Gender: Female, Male. Age: 0-17 years. Enrolment: 2.
Status: Authorised, recruitment pending. Decision date: 2023-10-05. Results received: No. Last updated: 2023-10-05.

Condition(s): Otoferlin gene-mediated hearing loss
Product: AAVAnc80-hOTOF

Primary endpoint: Frequency of AEs with relationship to the investigational medicinal product and/or to the administration procedure (including the delivery device, used as part of a delivery system), if able to be determined.
Endpoint(s): Change from baseline in diagnostic auditory brainstem response (ABR) testing threshold.

Source: https://euclinicaltrials.eu/ctis-public/view/2023-505128-76-00